EU clinical trial 2025-523959-65-00: ADCX-020 for the treatment of patients with locally advanced or metastatic cancers
Protocol code: ADCX-020-01
Sponsor: Adcytherix (Pharmaceutical company). Phase: Human Pharmacology (Phase I)- First administration to humans. Countries: Spain (ongoing, recruiting).
Therapeutic area(s): Not possible to specify
Gender: Female, Male. Age: 18-64 years, 65+ years. Enrolment: 55.
Status: Ongoing, recruiting. Start date (EU): 2026-03-17. Decision date: 2026-02-23. Results received: No. Last updated: 2026-06-01.

Condition(s): Locally Advanced or Metastatic Solid Tumors

Source: https://euclinicaltrials.eu/ctis-public/view/2025-523959-65-00